EU clinical trial 2024-511864-95-00: BARICITINIB IN CALCIUM PYROPHOSPHATE DIHYDRATE DEPOSITION DISEASE – A PROOF OF CONCEPT PHASE II CLINICAL TRIAL
Protocol code: BAPTIST (L4194)
Sponsor: Ospedale Galeazzi S.p.A. (Hospital/Clinic/Other health care facility). Phase: Therapeutic exploratory (Phase II). Countries: Italy (ongoing, recruiting).
Therapeutic area(s): Diseases [C] - Musculoskeletal Diseases [C05]
Gender: Female, Male. Age: 18-64 years, 65+ years. Enrolment: 32.
Status: Ongoing, recruiting. Start date (EU): 2025-01-08. Decision date: 2024-09-17. Results received: No. Last updated: 2026-06-30.

Condition(s): calcium pyrophosphate deposition disease
Product: METHOTREXATE, Olumiant 4 mg film-coated tablets, FOLIC ACID, COLCHICINE, METHYLPREDNISOLONE, HYDROXYCHLOROQUINE

Primary endpoint: Change from baseline in CD68 at 12 weeks.
Endpoint(s): Change from baseline in Krenn synovitis score at 12 weeks, Change from baseline in CD3, CD8, CD20 at synovial level at 12 weeks, Change from baseline in DAS, HAQ score and WOMAC at 4, 12 and 24 weeks., Change from baseline in MSUS EULAR-OMERACT synovitis score at 4, 12 and 24 weeks, CPP deposition extent according to the OMERACT CPPD scoring system at 4, 12 and 24 weeks and degenerative changes at 4, 12 and 24 weeks., Change from baseline in serum cytokines levels (IL-1, IL-6, IL-8, anti-TNFα, Interferon α and γ, TGF-β) at 12 and 24 weeks, Change from baseline in visual analogic scale (VAS) pain at 4, 12 and 24 weeks

Source: https://euclinicaltrials.eu/ctis-public/view/2024-511864-95-00